EU clinical trial 2023-508417-16-00: Esketamine As treatment for chronic pain due to endometrioSis: a RCT studY
Protocol code: EASYlight-NEK
Sponsor: Reinier de Graaf Groep (Hospital/Clinic/Other health care facility). Phase: Therapeutic use (Phase IV). Countries: Netherlands (ongoing, recruiting).
Therapeutic area(s): Diseases [C] - Female Urogenital Diseases and Pregnancy Complications [C13]; Analytical, Diagnostic and Therapeutic Techniques and Equipment [E] - Anesthesia and Analgesia [E03]
Gender: Female. Age: 18-64 years. Enrolment: 56.
Status: Ongoing, recruiting. Start date (EU): 2024-02-14. Decision date: 2024-01-18. Results received: No. Last updated: 2024-07-05.

Condition(s): Endometriosis
Product: SODIUM CHLORIDE, Ondansetron Morningside 4 mg orodispergeerbare tabletten, Ondansetron 2 mg/ml Solution for Injection, Ketanest® S 5 mg/ml - Ampullen

Primary endpoint: NRS score for chronic pelvic pain 4 weeks after the 8 hour infusion treatment
Endpoint(s): Pain scores (NRS scores for dysmenorrhea, dyschezia, dysuria, dyspareunia and chronic pelvic pain), Treatment experience (including side-effects) (Bond&Ladder questionnaire, Bowdle questionnaire, treatment experience rating (on a scale of 0-10), Depressive symptoms (HADS), Quality of life (EHP-30, EQ-5D-5L), Cost-effectiveness (adjusted iPCQ, adjusted iMCQ), Pain coping and cognition (PCCL)

Source: https://euclinicaltrials.eu/ctis-public/view/2023-508417-16-00